EU clinical trial 2023-505263-37-00: The effect of the Popliteal Plexus Block on the motor function of the leg - a randomized, controlled, blinded study in volunteers
Sponsor: Region Midtjylland (Hospital/Clinic/Other health care facility). Phase: Phase III and phase IV (Integrated). Countries: Denmark (ended).
Therapeutic area(s): Analytical, Diagnostic and Therapeutic Techniques and Equipment [E] - Anesthesia and Analgesia [E03]
Gender: Female, Male. Age: 18-64 years. Enrolment: 40.
Status: Ended. Start date (EU): 2023-09-27. End date (EU): 2023-10-19. Decision date: 2023-07-24. Results received: Yes. Last updated: 2023-07-24.

Condition(s): Acute post surgical pain after knee surgery
Product: Propofol ”B. Braun” 10 mg/ml, injektions- og infusionsvæske, emulsion, Xylocain, injektionsvæske, opløsning

Primary endpoint: Difference between group A, B and C in post block MVIC by ankle plantarflexion, expressed as a percentage of the pre block value, Difference between group A, B and C in post block MVIC by ankle dorsiflexion, expressed as a percentage of the pre block value
Endpoint(s): Difference between group A, B and C in post block MVIC by knee extension, expressed as a percentage of the pre block value, Difference between group A, B and C, in the number of volunteers with affected cMAP post block of the gastrocnemius muscle, Difference between group A, B and C, in the number of volunteers with affected cMAP post block of the tibialis anterior muscle., Difference between group A, B and C, in the number of volunteers with affected cMAP post block of the vastus medialis muscle., Difference between group A, B and C, in the number of volunteers with affected cMAP post block of the vastus lateralis muscle., Difference between group A, B and C in the number of volunteers with an affected saphenous nerve post block, evaluated by the sensory test.

Source: https://euclinicaltrials.eu/ctis-public/view/2023-505263-37-00